EU clinical trial 2023-508797-28-00: The Attractive 2 trial – An open-label, randomised, 2-period cross-over trial to assess the pharmacokinetics of ATR-258 oral capsule vs. oral solution formulations in healthy volunteers
Protocol code: ATR-258-trial-2
Sponsor: Atrogi AB (Pharmaceutical company). Phase: Human Pharmacology (Phase I)- Other. Countries: Sweden (ended).
Therapeutic area(s): Diseases [C] - Nutritional and Metabolic Diseases [C18]
Gender: Female, Male. Age: 18-64 years, 65+ years. Enrolment: 12.
Status: Ended. Start date (EU): 2024-04-24. End date (EU): 2024-05-27. Decision date: 2024-02-22. Results received: No. Last updated: 2024-02-22.

Condition(s): Type 2 diabetes (T2D)

Source: https://euclinicaltrials.eu/ctis-public/view/2023-508797-28-00